EU clinical trial 2024-517390-24-00: CHIPOR : Randomized phase III study evaluating hyperthermic intraperitoneal chemotherapy in the treatment of ovarian cancer relapse
Protocol code: UC-0120/1004
Sponsor: Unicancer (Hospital/Clinic/Other health care facility). Phase: Therapeutic confirmatory (Phase III). Countries: France (ongoing, recruiting).
Therapeutic area(s): Diseases [C] - Neoplasms [C04]
Gender: Female, Male. Age: 18-64 years, 65+ years. Enrolment: 383.
Status: Ongoing, recruiting. Start date (EU): 2011-04-26. Decision date: 2024-09-25. Results received: No. Last updated: 2024-09-25.

Condition(s): Ovarian epithelial cancer : intraperitoneal resectable relapse
Product: CISPLATIN

Primary endpoint: The date of death, whatever its cause, will be the main parameter used to evaluate overall survival.
Endpoint(s): Relapse-free Survival : Relapse-free survival will be defined as the absence of clinical evidence (presence of mass, or effusion with cytological diagnostic), biological criteria (confirmed elevation of CA 125 markers according to RUSTIN criteria) or medical imaging criteria (detection of measurable mass, with the new RECIST criteria). The main criteria will be the date at which relapse occurrence is detected., Pain and Quality of Life : Quality of life (QoL) will be studied with the QLQ C30 form from EORTC and FACT O form specific for ovarian cancer (functional assessment of cancer therapy for ovarian cancer). Pain will be evaluated with VAS. History of chronic pain will be noted and accounted for in the analysis., Treatment Toxicity, renal toxicity in particular, will be evaluated with the CTC-AE v4.0 scale, Morbidity : Morbidity evaluation will be performed until the 60th day after surgery, taking into account: - deaths - severe complications, Medico-economic study: collection of socio-demographical data and patient management costs., Pharmacokinetic study: on 50 patients included who received HIPEC (25 in the open method and 25 in the closed method: Analysis of platinum concentrations at the peritoneal, plasma and tissue levels.

Source: https://euclinicaltrials.eu/ctis-public/view/2024-517390-24-00